EU clinical trial 2023-505266-29-00: FIPO23 Phase I/II, multi center, Open Label, First-in-human, Dose Escalation and Expansion study to investigate the Safety, Pharmacokinetics, and anti-tumors efficacy of the glyco-humanized polyclonal antibody XON7 in patients with advanced or metastatic solid tumors.
Protocol code: XT-23-01 / FIPO23
Sponsor: Xenothera (Pharmaceutical company). Phase: Phase I and Phase II (Integrated)- First administration to humans. Countries: France (ongoing, recruiting), Belgium (ongoing, recruiting).
Therapeutic area(s): Diseases [C] - Neoplasms [C04]
Gender: Female, Male. Age: 18-64 years, 65+ years. Enrolment: 246.
Status: Ongoing, recruiting. Start date (EU): 2023-11-14. Decision date: 2023-09-11. Results received: No. Last updated: 2026-03-18.
Decision dates by country: BE: 2023-09-11, FR: 2023-09-11

Condition(s): Advanced or metastatic solid tumors

Source: https://euclinicaltrials.eu/ctis-public/view/2023-505266-29-00